EU clinical trial 2025-520478-20-00: A Phase 3, Multicenter, Randomized, Open-Label, Study to Evaluate REGN7508, A Factor XI Monoclonal Antibody, Versus Apixaban and Enoxaparin for Prophylaxis of Venous Thromboembolism After Elective Total Knee Arthroplasty (ROXI-APEX).
Protocol code: R7508-DVT-24116
Sponsor: Regeneron Pharmaceuticals Inc. (Pharmaceutical company). Phase: Therapeutic confirmatory (Phase III). Countries: Bulgaria (ongoing, recruiting), Lithuania (ongoing, recruiting), Poland (ongoing, recruiting), Hungary (ongoing, recruiting), Latvia (ongoing, recruiting), Romania (ongoing, recruiting).
Therapeutic area(s): Diseases [C] - Hemic and Lymphatic Diseases [C15]; Diseases [C] - Cardiovascular Diseases [C14]
Gender: Female, Male. Age: 18-64 years, 65+ years. Enrolment: 1087.
Status: Ongoing, recruiting. Start date (EU): 2025-11-05. Decision date: 2025-10-08. Results received: No. Last updated: 2026-06-17.
Decision dates by country: PL: 2025-10-10, LV: 2025-10-08, LT: 2025-10-08, RO: 2026-02-23, BG: 2025-10-09, HU: 2025-10-13

Condition(s): Thromboembolic disease
Product: REGN7508, REGN7508, SODIUM CHLORIDE, CLEXANE 4 000 UI (40 mg)/0,4 ml solution injectable en seringue préremplie, Eliquis 2.5 mg film-coated tablets

Primary endpoint: Incidence of the composite endpoint of asymptomatic or symptomatic Venous Thromboembolism (VTE) [including VTE-related death].
Endpoint(s): Time-to-first event of the composite endpoint of asymptomatic or symptomatic VTE (including VTE-related death), Incidence of confirmed symptomatic Deep Venous Thrombosis (DVT)., Incidence of confirmed Pulmonary Embolism (PE)., Incidence of VTE-related death., Time-to-first event of confirmed symptomatic DVT, Time-to-first event of confirmed PE, Time to VTE-related death, Incidence of the composite endpoint of major and clinically relevant nonmajor (CRNM) bleeding., Incidence of the composite endpoint of asymptomatic or symptomatic VTE (including VTE-related death)., Incidence of minor bleeding., Incidence of Treatment Emergent Adverse Events (TEAEs)., Occurrence of Anti-Drug Antibodies (ADA) to REGN7508., Magnitude of ADA to REGN7508., Concentrations of REGN7508.

Source: https://euclinicaltrials.eu/ctis-public/view/2025-520478-20-00